EU clinical trial 2023-505964-13-00: A phase IIIb, Multicenter, Open-Label, Single-Arm Study to Evaluate the Efficacy, Safety, Pharmacokinetics, and Pharmacodynamics of Subcutaneous Emicizumab in Patients From Birth to 12 Months of Age with Hemophilia A without Inhibitors
Protocol code: MO41787
Sponsor: F. Hoffmann-La Roche AG (Pharmaceutical company). Phase: Therapeutic confirmatory (Phase III). Countries: Italy (ongoing, recruitment ended), France (ongoing, recruitment ended), Belgium (ongoing, recruitment ended), Spain (ongoing, recruitment ended), Germany (ongoing, recruitment ended), Austria (ongoing, recruitment ended).
Therapeutic area(s): Diseases [C] - Hemic and Lymphatic Diseases [C15]
Gender: Male. Age: 0-17 years. Enrolment: 31.
Status: Ongoing, recruitment ended. Start date (EU): 2021-03-09. Decision date: 2024-03-06. Results received: No. Last updated: 2025-10-31.
Decision dates by country: AT: 2024-04-08, IT: 2024-03-20, ES: 2024-03-06, DE: 2024-03-07, FR: 2024-03-08, BE: 2024-03-21

Condition(s): Hemophilia A
Product: Hemlibra 150 mg/mL solution for injection, Hemlibra 30 mg/mL solution for injection

Primary endpoint: 1. Number of treated bleeds over time, 2. Number of all bleeds over time, 3. Number of treated spontaneous bleeds over time, 4. Number of treated joint bleeds over time, 5. Joint health, as assessed through use of the Hemophilia Joint Health Score (HJHS) and magnetic resonance imaging (MRI) score of specific joints at specified timepoints only during the 7-year long-term follow-up (LTFU) period, 6. Incidence and severity of adverse events, with severity determined according to WHO Toxicity Grading Scale, 7. Incidence of thromboembolic events and thrombotic microangiopathy (TMA), 8. Change from baseline in physical examination findings, 9. Change from baseline in vital signs, 10. Incidence of laboratory abnormalities, 11. Incidence and severity of injection-site reactions, 12. Incidence of adverse events leading to study drug discontinuation, 13. Incidence of severe hypersensitivity, anaphylaxis, and anaphylactoid events, 14. Plasma trough concentrations (Ctrough) of emicizumab prior to study drug administration, 15. Effect of emicizumab on PD parameters, including aPTT, thrombin generation (TG), and reported FVIII activity, as well as FIX antigen and FX antigen (emicizumab substrates) levels prior to study drug

Source: https://euclinicaltrials.eu/ctis-public/view/2023-505964-13-00